EU clinical trial 2022-500609-42-00: A Phase 2a/2b, Open-label, Proof of Concept (Phase 2a) and Open-label (Phase 2b), Multicenter, Efficacy, and Safety Study of AG-946in Participants With Anemia Due to Lower-Risk Myelodysplastic Syndromes
Protocol code: AG946-C-002
Sponsor: Agios Pharmaceuticals Inc. (Pharmaceutical company). Phase: Therapeutic exploratory (Phase II). Countries: Spain (ongoing, recruitment ended), France (ended), Germany (ended), Poland (ongoing, recruitment ended), Italy (ongoing, recruitment ended), Greece (ended), Czechia (ended), Austria (ended).
Therapeutic area(s): Diseases [C] - Hemic and Lymphatic Diseases [C15]
Gender: Female, Male. Age: 18-64 years, 65+ years. Enrolment: 78.
Start date (EU): 2023-02-24. Decision date: 2023-01-23. Results received: No. Last updated: 2025-12-09.
Decision dates by country: AT: 2023-02-06, CZ: 2023-02-03, GR: 2023-01-31, DE: 2023-01-27, FR: 2023-01-23, IT: 2023-01-30, ES: 2023-01-24, PL: 2023-02-06

Condition(s): Anemia Due to Lower-Risk Myelodysplastic Syndromes
Product: AG-946, AG-946

Primary endpoint: Phase 2a 1. Hemoglobin (Hb) response, defined as a≥1.5-g/dL increase from baseline in the average Hb concentration from Week 8 through Week16 2 Transfusion independence (TI), defined as transfusion-free for ≥8consecutive weeks during the Core Period (participants with low transfusion burden [LTB] only), Phase 2b Transfusion independence, defined as transfusion-free for ≥8 consecutive weeks (TI8) during the Core Period
Endpoint(s): Phase 2a: 1. AEs, SAEs, discontinuations due to AEs, and laboratory abnormalities during the Core Period 2. Hb 1.0+ response, defined as a≥1.0-g/dL increase from baseline in the average Hb concentration from Week 8through Week16 3. Change from baseline in Hb concentration during the Core Period, Phase 2a: 4. ≥1.5-g/dL increase from baseline in the Hb concentration at ≥2 consecutive time points from Week 8 through Week 16 5. Change from baseline in total transfused red blood cell (RBC) units during the Core Period 6. ≥50% reduction in total transfused RBC units for ≥8 consecutive weeks during the Core Period compared with baseline, Phase 2a: 7. Plasma concentration and pharmacokinetic parameters of AG-946 during the Core Period 8. Whole blood concentrations of pharmacodynamic parameters, including 2,3-diphosphoglycerate (2,3-DPG) and adenosine triphosphate (ATP) during the Core Period, Phase 2b: 1. AEs, SAEs, discontinuations due to AEs, and laboratory abnormalities during the Core Period 2. Change from baseline in Hb concentration during the Core Period 3. Change from baseline in total transfused RBC units from Week 8 through Week 24, Phase 2b: 4. ≥50% reduction in total transfused RBC units for ≥8 consecutive weeks during the Core Period compared with baseline (participants with high transfusion burden [HTB] only) 5. Time to first TI8 during the Core Period 6. Transfusion-free for ≥12 consecutive weeks (TI12)during the Core Period, Phase 2b: 7. ≥50% reduction in total transfused RBC units for ≥12 consecutive weeks during the Core Period compared with baseline (participants with HTB only) 8. Time to first TI12 during the Core Period 9. Duration of TI, defined as the longest transfusion-free period during the Core Period, Phase 2b: 10. Plasma concentration and pharmacokinetic parameters of AG-946 during the Core Period 11. Whole blood concentrations of pharmacodynamic parameters, including 2,3-DPG and ATP during the Core Period

Source: https://euclinicaltrials.eu/ctis-public/view/2022-500609-42-00